EU clinical trial 2023-505291-30-01: CAPPA : A Phase II study to evaluate CAPecitabine plus Pembrolizumab as postoperative Adjuvant therapy for Triple Negative Breast Cancer with residual disease after neoadjuvant chemo-immunotherapy
Protocol code: UC-BCG-2211, CAPPA
Sponsor: Unicancer (Hospital/Clinic/Other health care facility). Phase: Therapeutic exploratory (Phase II). Countries: France (ongoing, recruiting).
Therapeutic area(s): Diseases [C] - Neoplasms [C04]
Gender: Female, Male. Age: 18-64 years, 65+ years. Enrolment: 220.
Status: Ongoing, recruiting. Start date (EU): 2025-03-06. Decision date: 2024-11-14. Results received: No. Last updated: 2024-11-14.

Condition(s): Triple Negative Breast Cancer with residual disease after neoadjuvant chemo-immunotherapy.
Product: CAPECITABINE, CAPECITABINE, PEMBROLIZUMAB

Primary endpoint: 2-year Invasive disease free survival (iDFS).
Endpoint(s): Efficacy: Overall Survival (OS) is defined as the time from the date of inclusion to the date of death due to any cause. For patients alive, OS will be censored at date of last contact., Efficacy: Distant disease-free survival (DDFS) is defined as the time from the date of inclusion to the date of distant relapse or death due to any cause. For patients alive without distant relapse, DDFS will be censored at date of last contact., Efficacy : iDFS, OS and DDFS will also be compared to the external cohort of TNBC patients without pCR after NAC and treated with adjuvant pembrolizumab as part of standard of care after surgery, Safety : Safety and tolerability assessed by Adverse Events (AEs) as per the National Cancer Institute Common Toxicity Criteria for Adverse Events version 5.0 (CTCAE v5.0).

Source: https://euclinicaltrials.eu/ctis-public/view/2023-505291-30-01